EU clinical trial 2024-512146-41-00: A Phase 1/2 Study of Etentamig in Combination with a CELMoD Agent for the Treatment of Patients with Relapsed/Refractory Multiple Myeloma
Protocol code: M24-555
Sponsor: AbbVie Deutschland GmbH & Co. KG (Pharmaceutical company). Phase: Phase I and Phase II (Integrated)- Other. Countries: France (ongoing, recruiting), Norway (ongoing, recruiting), Netherlands (ongoing, recruiting).
Therapeutic area(s): Diseases [C] - Neoplasms [C04]
Gender: Female, Male. Age: 18-64 years, 65+ years. Enrolment: 55.
Status: Ongoing, recruiting. Start date (EU): 2025-07-29. Decision date: 2025-07-08. Results received: No. Last updated: 2026-03-19.
Decision dates by country: NL: 2025-07-14, NO: 2025-07-14, FR: 2025-07-08

Condition(s): Multiple Myeloma
Product: Iberdomide, Iberdomide, Etentamig, Iberdomide, Iberdomide

Primary endpoint: Dose-limiting toxicities (DLT) of etentamig when given in combination with Iberdomide in subjects with Relapsed/Refractory Multiple Myeloma.
Endpoint(s): Response rate (RR): Partial Response (PR), Very Good Partial Response (VGPR), Complete Response (CR), stringent Complete Response (sCR), Overall Response Rate (ORR), Progression-free survival (PFS), Duration of response (DOR), Time-to-progression (TTP), Minimal Residual Disease (MRD) negativity

Source: https://euclinicaltrials.eu/ctis-public/view/2024-512146-41-00